EU clinical trial 2025-524069-26-00: Evaluation of hANP for prevention of acute kidney injury after cardiac surgery: A two-part randomized controlled trial with open-label extension in children aged 0–12 months.
Protocol code: ELIAS
Sponsor: Vaestra Goetalandsregionen (Hospital/Clinic/Other health care facility). Phase: Therapeutic exploratory (Phase II). Countries: Sweden (authorised, recruitment pending).
Therapeutic area(s): Analytical, Diagnostic and Therapeutic Techniques and Equipment [E] - Therapeutics [E02]
Gender: Female, Male. Age: 0-17 years. Enrolment: 100.
Status: Authorised, recruitment pending. Decision date: 2026-05-11. Results received: No. Last updated: 2026-05-11.

Condition(s): Acute kidney injury (AKI) occurring in newborns and infants after cardiac surgery with cardiopulmonary bypass. The study targets early postoperative renal dysfunction and fluid imbalance in this high-risk population.
Product: HANP injection 1000

Primary endpoint: The primary endpoint of this trial is the change in measured creatinine clearance (CrCl) from baseline (T0) to 5 hours after start of the investigational product infusion (T1). CrCl will be calculated using concurrent timed urine collection and plasma creatinine measurements. This endpoint is chosen as a sensitive surrogate for GFR and reflects short-term renal functional response to the intervention.
Endpoint(s): Incidence and severity of AKI at 48 hours post-surgery (POD2), defined according pRIFLE and KDIGO criteria., Urine output (mL/kg/h) during the first 48 postoperative hours., Cumulative fluid balance and percentage fluid overload (%FO) during the first 48 postoperative hours., Changes in renal biomarkers and indices related to kidney injury and repair (e.g., NGAL, KIM-1, cystatin C, and others listed in Appendix 1–2)., Cl-urea and temporal trends in CrCl and Cl-urea at predefined time points (T0, T1, T2)., Subgroup comparisons of renal outcomes stratified by cardiopulmonary bypass duration and other predefined subgroups., Comparison of AKI incidence at POD2 with an external matched reference cohort from another Nordic center.

Source: https://euclinicaltrials.eu/ctis-public/view/2025-524069-26-00